EU clinical trial 2024-514542-37-00: Phase 1 / 2 Multicenter Study of the Safety, Pharmacokinetics, and Preliminary Efficacy of APL-101 in Subjects with Non-Small Cell Lung Cancer with c-Met Exon14 Skip Mutations and c-Met Dysregulation Advanced Solid Tumors
Protocol code: APL-101-01
Sponsor: Apollomics Inc. (Pharmaceutical company). Phase: Phase I and Phase II (Integrated)- Other. Countries: France (ongoing, recruiting), Italy (ongoing, recruiting), Spain (ongoing, recruiting), Hungary (ended).
Therapeutic area(s): Diseases [C] - Neoplasms [C04]
Gender: Female, Male. Age: 18-64 years, 65+ years. Enrolment: 271.
Start date (EU): 2020-08-13. Decision date: 2024-07-22. Results received: No. Last updated: 2024-10-01.
Decision dates by country: FR: 2024-09-10, HU: 2024-07-23, IT: 2024-07-29, ES: 2024-07-22

Condition(s): Select advanced solid tumors and Non-Small Cell Lung Cancer with MET aberrations
Product: APL-101

Primary endpoint: 1. Phase 1 (Completed): Estimate the MTD and the incidence of DLTs in Cycle 1, sustained Grade 2 AEs, dose reductions, dose interruptions and any occurrences of delayed toxicities and other AEs to determine the RP2D dosing of APL-101, 2. Phase 2: Objective response rate (ORR; defined as complete response [CR] + partial response [PR]) per independent review committee (IRC) based on RECIST v1.1 criteria, RANO criteria for CNS tumors, or other relevant criteria per tumor type.
Endpoint(s): 1. Median duration of response (DOR) per IRC., 2. ORR per investigator assessment based on RECIST v1.1 criteria, RANO criteria for CNS tumors, or other relevant criteria per tumor type., 3. Median DOR per investigator assessment., 4. Antitumor activity by clinical benefit rate (CR + PR + SD ≥ 4 cycles) based on RECIST v1.1 criteria, RANO criteria for CNS tumors, or other relevant criteria per tumor type., 5. Median time to progression (TTP)., 6. Progression-free survival (PFS) and overall survival (OS) at 6, 12, 18, and 24 months.

Source: https://euclinicaltrials.eu/ctis-public/view/2024-514542-37-00